EU clinical trial 2024-515445-42-00: Elacestrant versus Standard Endocrine Therapy in Women and Men with Node positive, Estrogen Receptor-positive, HER2-negative, Early Breast Cancer with High Risk of Recurrence - A Global, Multicenter, Randomized, Open-label Phase 3 Study (ELEGANT)
Protocol code: STML-ELA-0422
Sponsor: Stemline Therapeutics Inc. (Pharmaceutical company). Phase: Therapeutic confirmatory (Phase III). Countries: Italy (ongoing, recruiting), France (ongoing, recruiting), Romania (ongoing, recruiting), Spain (ongoing, recruiting), Sweden (ended), Belgium (ongoing, recruiting), Poland (ongoing, recruiting), Austria (ongoing, recruiting), Netherlands (ongoing, recruiting), Hungary (ongoing, recruiting), Germany (ongoing, recruiting), Czechia (ongoing, recruiting), Portugal (ongoing, recruiting), Finland (ongoing, recruiting), Denmark (ongoing, recruiting).
Therapeutic area(s): Diseases [C] - Neoplasms [C04]
Gender: Female, Male. Age: 18-64 years, 65+ years. Enrolment: 2126.
Start date (EU): 2025-03-24. Decision date: 2025-03-11. Results received: No. Last updated: 2026-06-22.
Decision dates by country: SE: 2025-03-12, ES: 2025-03-11, RO: 2025-03-17, FI: 2025-06-11, IT: 2025-03-12, FR: 2025-03-14, DK: 2025-06-06, NL: 2025-03-13, DE: 2025-04-11, PL: 2025-03-16, PT: 2025-05-02, AT: 2025-03-17, CZ: 2025-04-15, HU: 2025-03-13, BE: 2025-03-11

Condition(s): Node-positive, Estrogen Receptor-positive, HER2-negative, Early Breast Cancer with High Risk of Recurrence
Product: TAMOXIFEN, ANASTROZOLE, EXEMESTANE, ELACESTRANT, ELACESTRANT, LETROZOLE

Primary endpoint: IBCFS: the time from date of randomization to the date of first occurrence of: • ipsilateral invasive breast tumor recurrence, • local/regional invasive breast cancer recurrence, • distant recurrence, • contralateral invasive breast cancer, or • death attributable to any cause.
Endpoint(s): DRFS: the time from randomization to distant recurrence or death from any cause, whichever occurred first., OS: the time from randomization to death from any cause., IDFS: the time from randomization to the first occurrence of local or regional recurrence, contralateral recurrence, second primary non-breast invasive cancer, distant recurrence, or death attributable to any cause., Adverse events (AEs), treatment emergent adverse events (TEAEs) and serious adverse events (SAEs) as well as changes in clinical laboratory values and vital sign measurements., Change from baseline in the global health status quality of life scale score at 6 and 12 months and annually thereafter, as assessed by the European Organization for the Research and Treatment of Cancer Quality of Life Questionnaire Core 30 (EORTC QLQ-C30)., Change from baseline in the physical functioning sub-scale score at 6 and 12 months and annually thereafter, as assessed by EORTC QLQ-C30., Change from baseline in the breast cancer Endocrine Therapy Symptoms sub-scale score at 6 and 12 months and annually thereafter, as assessed by the European Organization for the Research and Treatment of Cancer Quality of Life Questionnaire Breast Cancer module (EORTC QLQ-BR42)., Change from baseline in side effects/tolerability at 6 and 12 months and annually thereafter, as assessed by the Question 168 of the European Organization for the Research and Treatment of Cancer Question Library (EORTC Q168)., Elacestrant PK parameters, exposure-response analyses between elacestrant PK and efficacy/safety endpoints.

Source: https://euclinicaltrials.eu/ctis-public/view/2024-515445-42-00